EU clinical trial 2023-506873-36-00: A Phase 3, Multicenter, Randomized, Double-Blind, Placebo-Controlled Study to Evaluate the Efficacy and Safety of AL001 in Individuals at Risk For or With Frontotemporal Dementia Due to Heterozygous Mutations in the Progranulin Gene
Sponsor: Alector LLC (Pharmaceutical company). Phase: Therapeutic confirmatory (Phase III). Countries: Greece (ended), Germany (ended), Belgium (ended), Italy (ended), Sweden (ended), Portugal (ended), Netherlands (ended), Spain (ended), France (ended).
Therapeutic area(s): Diseases [C] - Nervous System Diseases [C10]
Gender: Female, Male. Age: 18-64 years, 65+ years. Enrolment: 79.
Status: Ended. Start date (EU): 2020-06-29. End date (EU): 2026-01-06. End date: 2026-01-07. Decision date: 2024-10-18. Results received: Yes. Last updated: 2025-06-10.
Decision dates by country: GR: 2024-11-26, FR: 2024-10-22, ES: 2024-10-18, IT: 2024-10-22, NL: 2024-10-22, PT: 2024-10-18, BE: 2024-10-18, DE: 2024-10-22, SE: 2024-10-18

Condition(s): Frontotemporal dementia (FTD)
Product: latozinemab, Placebo: sterile solution for intravenous infusion

Primary endpoint: Change from baseline to Weeks 48, 72, and 96 in the CDR® plus NACC FTLD-SB.
Endpoint(s): Change from baseline to Weeks 48, 72, and 96 on the CGI-S., Actual values at Weeks 48, 72, and 96 on the CGI-I., Change from baseline to Weeks 48, 72, and 96 on the RBANS.

Source: https://euclinicaltrials.eu/ctis-public/view/2023-506873-36-00